EU clinical trial 2023-508242-18-00: Management of moderate POstoperative recurrence in Crohn's disease: a randoMizEd contROLled trial of therapeutic escalation, the POMEROL trial
Protocol code: GETAID-2021-01
Sponsor: Groupe D'etude Therapeutique Des Affections Inflammatoires Du Tube Digestif (Laboratory/Research/Testing facility). Phase: Therapeutic use (Phase IV). Countries: France (ongoing, recruitment ended), Belgium (ongoing, recruitment ended), Spain (ongoing, recruitment ended).
Therapeutic area(s): Diseases [C] - Digestive System Diseases [C06]
Gender: Female, Male. Age: 18-64 years, 65+ years. Enrolment: 185.
Status: Ongoing, recruitment ended. Start date (EU): 2021-12-21. Decision date: 2023-11-06. Results received: No. Last updated: 2025-09-17.
Decision dates by country: FR: 2023-11-06, BE: 2024-05-27, ES: 2024-04-30

Condition(s): Crohn's disease
Product: Remsima 100 mg powder for concentrate for solution for infusion, Remsima 120 mg solution for injection in pre-filled pen

Primary endpoint: The primary endpoint will be the proportion of patients with a treatment success defined as an i0-i1 modified Rutgeerts score (mRS) at 12 months (M12) (See Appendix for the description of the score).
Endpoint(s): Proportion of patients with an i3-i4 modified Rutgeerts score at 12 months, Proportion of patients with an i2b-i3-i4 modified Rutgeerts score at 12 months, Proportion of patients with an i0 modified Rutgeerts score at 12 months, Two item Patient Reported Outcome (PRO2) at 12 months (18) (M12), Clinical postoperative recurrence within 12 months after randomization : average daily stool frequency ≥ 3.5 AND average daily abdominal pain score ≥ 1.5 (19), AND increased CRP compared to inclusion, at least + 10 mg/l OR increased fecal calprotectin compared to inclusion, at least + 250 μg/g, Surgical recurrence within 12 months: need for a new ileocolonic resection, Endoscopic dilatation within 12 months: need for a balloon insufflation at the ileocolonic anastomosis during an ileocolonoscopy when a non-passable stenosis was present in patient having obstructive symptoms (CDOS > 4) before endoscopy, Time to clinical postoperative recurrence, Serious adverse events, Quality of life: EQ5D-5L questionnaire, Work productivity: Work Productivity and Activity Impairment questionnaire

Source: https://euclinicaltrials.eu/ctis-public/view/2023-508242-18-00